EU clinical trial 2022-500531-36-00: A randomized, double-blind, placebo-controlled, multi-center Phase 2b study with a blinded extension and an optional open-label extension—assessing the safety and efficacy of frexalimab, a CD40L-antagonist monoclonal antibody, for the preservation of pancreatic β-cell function in adults, adolescents and children with newly diagnosed type 1 diabetes on insulin therapy
Protocol code: DRI17476
Sponsor: Sanofi-Aventis Recherche & Developpement (Pharmaceutical company). Phase: Therapeutic exploratory (Phase II). Countries: Spain (ongoing, recruitment ended), Denmark (ongoing, recruitment ended), Sweden (ongoing, recruitment ended), Belgium (ongoing, recruitment ended), Czechia (ongoing, recruitment ended), Germany (ongoing, recruitment ended), Italy (ongoing, recruitment ended), Poland (ongoing, recruitment ended), Hungary (ongoing, recruitment ended), France (ongoing, recruitment ended), Austria (ongoing, recruitment ended), Slovenia (ongoing, recruitment ended), Finland (ongoing, recruitment ended).
Therapeutic area(s): Diseases [C] - Nutritional and Metabolic Diseases [C18]
Gender: Female, Male. Age: 0-17 years, 18-64 years. Enrolment: 291.
Status: Ongoing, recruitment ended. Start date (EU): 2024-02-02. Decision date: 2023-12-18. Results received: No. Last updated: 2026-08-01.
Decision dates by country: SE: 2023-12-18, DK: 2023-12-18, ES: 2023-12-18, FR: 2024-01-02, SI: 2025-04-30, CZ: 2023-12-19, AT: 2025-06-11, FI: 2025-06-18, IT: 2023-12-20, HU: 2023-12-20, BE: 2023-12-19, DE: 2023-12-21, PL: 2023-12-21

Condition(s): Type 1 diabetes mellitus

Primary endpoint: Change in mean 2h mixed meal tolerance test (MMTT) stimulated C-peptide concentration, calculated from AUC from baseline to W52 for Part B (12-21 y.o.), Change in mean 2h mixed meal tolerance test (MMTT) stimulated C-peptide concentration, calculated from AUC from baseline to W26 for Part C (6-11 y.o.)
Endpoint(s): Time in range (70-180 mg/dL), assessed by study CGM at W52 and W104(part B), Time in tight range (TITR, 70 – 140 mg/dL), assessed by study CGM at W52 and W104(part B), Change from baseline to W104 in mean 2h mixed meal tolerance test (MMTT) stimulated C-peptide concentration, calculated from AUC(Part B), Proportion of participants who remain C-peptide positive (mean 2h MMTT stimulated C-peptide concentration ≥0.2 nmol/L) at W52 and W104(part B), Proportion of participants with reduction from baseline to W52 and W104 of less than 10% in mean 2h MMTT stimulated C-peptide concentration(Part B), Proportion of participants with partial remission at W52 and W104 (defined as IDAA1c score ≤9.0, where it is calculated as HbA1c [%] + 4x insulin dose [IU/kg/day])(Part B), Change from baseline to W52 and W104 in insulin dose [IU/kg/day] (part B), Change from baseline to W52 and W104 in insulin dose [IU/kg/day](part B), HbA1c level and its change from baseline at W52 and W104(part B), Proportion of participants with HbA1c ≤6.5% and requiring no injections of exogenous insulin at W52 and W104(part B), Proportion of participants with HbA1c ≤6.5% and requiring ≤0.25 IU of insulin at W52 and W104(part B), Proportion of participants with HbA1c <7% at W52 and W104(part B), Incidence of treatment emergent adverse events (TEAEs), serious adverse events (SAEs), adverse events of special interest (AESIs) and TEAEs leading to treatment discontinuation, Number of participants with at least one hypoglycemic event, Number of participants with at least one hyperglycemic episode, Number of participants with at least one diabetic ketoacidosis (DKA) event, Number of participants with clinically significant changes in vital signs, electrocardiogram (ECG), and/or laboratory evaluation, Height and growth rate over time (for participants <18 y.o. at screening), Frexalimab plasma concentrations over time and PK parameters, Incidence of anti-drug antibodies (ADAs) over time, Change from baseline to W52 and W104 in PedsQL Diabetes Symptoms domain score (all participants≥8 y.o.) (part B), Change from baseline to W52 and W104 in Pediatric Quality of Life (PedsQL) Diabetes Management domain score (all participants≥8 y.o.) (part B), Change from baseline to W52 and W104 in Problem Areas In Diabetes (PAID) total score (all participants)(part B), Change from baseline to W52 and W104 in Diabetes Treatment Satisfaction Questionnaires (DTSQs) total and item scores (all participants)(part B), Change from baseline to W52 and W104 in PAID immediate and theoretical domain scores (caregivers of all participants 6-17 y.o.)(part B), Change from baseline to W52 and W104 in DTSQs Total and item scores (caregivers of all participants 6-17 y.o.)(part B), Time in range (70-180 mg/dL), assessed by study CGM at W26 and W52(part C), Time in tight range (TITR, 70 – 140 mg/dL), assessed by study CGM at W26 and W52(part C), Change from baseline to W52 in mean 2h mixed meal tolerance test (MMTT) stimulated C-peptide concentration, calculated from AUC(Part C), Proportion of participants who remain C-peptide positive (mean 2h MMTT stimulated C-peptide concentration ≥0.2 nmol/L) at W26 and W52(part C), Proportion of participants with reduction from baseline to W26 and W52 of less than 10% in mean 2h MMTT stimulated C-peptide concentration(Part C), Proportion of participants with partial remission at W26 and W52 (defined as IDAA1c score ≤9.0, where it is calculated as HbA1c [%] + 4x insulin dose [IU/kg/day]) (part C), Change from baseline to W26 and W52 in IDAA1c score(part C), Change from baseline to W26 and W52 in insulin dose [IU/kg/day] (part C), HbA1c level and its change from baseline at W26 and W52(part C), Proportion of participants with HbA1c ≤6.5% and requiring no injections of exogenous insulin at W26 and W52(part C), Proportion of participants with HbA1c ≤6.5% and requiring ≤0.25 IU of insulin at W26 and W52(part C), Proportion of participants with HbA1c <7% at W26 and W52(part C), Change from baseline to W26 and W52 in PedsQL Diabetes Symptoms domain score (all participants≥8 y.o.) (part C), Change from baseline to W26 and W52 in PedsQL Diabetes Management domain score (all participants≥8 y.o.) (part C), Change from baseline to W26 and W52 in Problem Areas In Diabetes (PAID) total score (all participants)(part C), Change in PedsQL Diabetes Symptoms and Management domains scores (caregivers of participants 6 -7 y.o.) from baseline to W26 and W52 (Part C), Change from baseline to W26 and W52 in PAID immediate and theoretical domain scores (caregivers of all participants 6-17 y.o.)(part C), Change from baseline to W26 and W52 in DTSQs Total and item scores (caregivers of all participants 6-17 y.o.)(part C)

Source: https://euclinicaltrials.eu/ctis-public/view/2022-500531-36-00